EU clinical trial 2025-523839-18-00: An open label, balanced, randomized, two-treatment, two-period, two-sequence, single-dose, crossover bioequivalence study comparing Deucravacitinib tablets 6 mg, Manufactured by Sun Pharmaceutical Industries Limited, India with SOTYKTU (deucravacitinib) tablets 6 mg, Distributed by Bristol-Myers Squibb Company, Princeton, New Jersey 08543 USA, in healthy, adult, human subjects under fed condition
Protocol code: DEUCR-08-25
Sponsor: Sun Pharmaceutical Industries Limited (Pharmaceutical company). Phase: Human Pharmacology (Phase I)- Bioequivalence Study. Countries: Romania (ended).
Therapeutic area(s): Diseases [C] - Immune System Diseases [C20]
Gender: Female, Male. Age: 18-64 years. Enrolment: 40.
Status: Ended. Start date (EU): 2026-03-24. End date (EU): 2026-05-22. Decision date: 2026-02-19. Results received: No. Last updated: 2026-02-19.

Condition(s): plaque psoriasis

Source: https://euclinicaltrials.eu/ctis-public/view/2025-523839-18-00